EU clinical trial 2025-523092-33-00: Effect of Vitamin D supplementation on MyocardIal Fibrosis in PaTients with Acute Myocarditis (EDIT-AM): a multicenter, open-label, randomized controlled trial
Protocol code: EDIT-AM
Sponsor: Spanish Society Of Cardiology (Laboratory/Research/Testing facility). Phase: Therapeutic confirmatory (Phase III). Countries: Spain (authorised, recruitment pending).
Therapeutic area(s): Diseases [C] - Cardiovascular Diseases [C14]
Gender: Female, Male. Age: 18-64 years, 65+ years. Enrolment: 152.
Status: Authorised, recruitment pending. Decision date: 2026-07-10. Results received: No. Last updated: 2026-07-10.

Condition(s): Myocardial fibrosis, Acute myocarditis
Product: CALCIFEDIOL MONOHYDRATE

Primary endpoint: Extent of LGE (percentage of left ventricle mass) at month 6 (central core laboratory-blinded analysis)
Endpoint(s): Percentage of participants with at least one event of cardiovascular mortality, heart failure hospitalisation or sustained ventricular arrhythmias from baseline to month 6, Burden of PVC on 24h Holter-ECG recording at month 6, Percentage of participants without LGE at month 6, Percentage of participants with LGE <5% (percentage of left ventricle mass) at month 6, ECV at month 6, T2 mapping values at month 6, 25-OHD serum levels at week 6 and month 6, High sensitivity troponin at week 6 and month 6, NT-ProBNP at week 6 and month 6, CRP at week 6 and month 6, Percentage of participants with 25OHD >100 ng/mL at week 6 and month 6, Percentage of participants with at least one episode of symptomatic hypervitaminosis D, Percentage of participants with calcium >10.5 mg/dL at week 6 and month 6, Percentage of participants with at least one episode of symptomatic hypercalcemia, CMR LVEF at month 6, CMR left ventricular diastolic and systolic volumes at month 6, CMR detection of regional wall motion abnormalities at month 6

Source: https://euclinicaltrials.eu/ctis-public/view/2025-523092-33-00